EU clinical trial 2022-500816-21-00: STOP-COPD Standard vs Targeted Oxygen Therapy Prehospital for Chronic Obstructive Pulmonary Disease
Sponsor: Præhospitalet (Hospital/Clinic/Other health care facility). Phase: Therapeutic use (Phase IV). Countries: Denmark (not authorised).
Therapeutic area(s): Diseases [C] - Respiratory Tract Diseases [C08]
Gender: Female, Male. Age: 18-64 years, 65+ years. Enrolment: 1888.
Status: Not authorised. Decision date: 2022-09-12. Results received: No. Last updated: 2022-09-12.

Condition(s): Acute Exacerbation of Chronic Obstructive Pulmonary Disease
Product: Salbutamol ”TEVA”, inhalationsvæske til nebulisator, opløsning, Conoxia 100 %, medicinsk gas, komprimeret, AIRAPY, komprimeret medicinsk gas, Berodual, inhalationsvæske til nebulisator, opløsning

Primary endpoint: 30-day mortality
Endpoint(s): 24-hour mortality, 7-day mortality, Length of hospitalization, ICU admission rate, Length of ICU admission, In-hospital need for non-invasive ventilation, Time to non-invasive ventilation, In-hospital need for invasive ventilation, Time to invasive ventilation, Proportion of patients with respiratory acidosis on arrival to hospital, The degree of acidosis based on the pH-value, Patient experienced dyspnoea on a verbal rating scale 0-10, Readmission rate

Source: https://euclinicaltrials.eu/ctis-public/view/2022-500816-21-00